EU clinical trial 2023-508656-19-00: Bioequivalence of Cladribine 10 mg from two different products
Protocol code: CPO23001
Sponsor: CCDRD Cooperative Clinical Drug Research and Development AG, Pharos Pharmaceutical Oriented Services Ltd. (Pharmaceutical company). Phase: Human Pharmacology (Phase I)- Bioequivalence Study. Countries: Bulgaria (ended).
Therapeutic area(s): Diseases [C] - Nervous System Diseases [C10]
Gender: Male. Age: 18-64 years. Enrolment: 76.
Status: Ended. Start date (EU): 2024-03-01. End date (EU): 2024-05-02. Decision date: 2024-02-06. Results received: No. Last updated: 2024-02-06.

Condition(s): No therapeutic indication in the current trial with healthy volunteers. The intended indication is for treatment of adult patients with highly active relapsing multiple sclerosis (MS).

Source: https://euclinicaltrials.eu/ctis-public/view/2023-508656-19-00